EU clinical trial 2022-502308-66-00: A Phase 1/2, randomized, dose-finding/dose-confirmation study to evaluate the reactogenicity, safety and immunogenicity of mRNA-based multivalent seasonal influenza vaccine candidates administered in healthy younger and older adults
Protocol code: 217884
Sponsor: GlaxoSmithKline Biologicals (Pharmaceutical company). Phase: Phase I and Phase II (Integrated)- First administration to humans. Countries: Belgium (ended).
Therapeutic area(s): Diseases [C] - Virus Diseases [C02]
Gender: Female, Male. Age: 18-64 years, 65+ years. Enrolment: 438.
Status: Ended. Start date (EU): 2023-04-27. End date (EU): 2024-07-02. End date: 2024-12-18. Decision date: 2023-04-19. Results received: Yes. Last updated: 2024-05-27.

Condition(s): Healthy volunteers (prevention of influenza infection)
Product: Alpharix-Tetra, suspensie voor injectie in een voorgevulde spuit Griepvaccin (gefragmenteerd, geïnactiveerd virion), Alpharix-Tetra, suspension injectable en seringue préremplie Vaccin antigrippal (virion fragmenté, inactivé), EFLUELDA, suspensie voor injectie in een voorgevulde spuit Quadrivalent griepvaccin (gesplitst virion, geïnactiveerd), 60 microgram HA/stam

Primary endpoint: Percentage of participants reporting each solicited administration site event (From Day 1 to Day 7), Percentage of participants reporting each solicited systemic event (From Day 1 to Day 7), Percentage of participants reporting unsolicited adverse events (AEs) (From Day 1 to Day 28), Percentage of participants reporting serious adverse events (SAEs) (From Day 1 to Day 183), Percentage of participants reporting adverse events of special interest (AESIs) (From Day 1 to Day 183), Percentage of participants reporting medically attended events (MAEs) (From Day 1 to Day 183), Percentage of participants reporting a shift from a non-clinically significant laboratory value on Day 1 (pre-dose) to a clinically significant abnormal laboratory value on Day 8 (post-dose) and/or Day 29 (post-dose) for hematology and clinical chemistry (Phase 1 only), Geometric mean titer (GMT) of antigen 1 antibody titer (Day 29), Geometric mean increase (GMI) of antigen 1 antibody titer (From Day 1 to Day 29), Percentage of participants with antigen 1 seroconversion rate (SCR) (From Day 1 to Day 29), Percentage of participants with antigen 1 titer >= cut off value (Day 1 and Day 29), GMT of antigen 2 antibody titer (Day 29), GMI of antigen 2 antibody titer (From Day 1 to Day 29), Percentage of participants with antigen 2 SCR (From day 1 to Day 29)
Endpoint(s): GMT of antigen 1 antibody titer (Day 92 and Day 183), GMI of antigen 1 antibody titer (From Day 1 to Day 92), GMI of antigen 1 antibody titer (From Day 1 to Day 183), Percentage of participants with antigen 1 titer >= cut off value (Day 183), GMT of antigen 2 antibody titer (Day 92 and Day 183), GMI of antigen 2 antibody titer (From Day 1 to Day 92), GMI of antigen 2 antibody titer (From Day 1 to Day 183)

Source: https://euclinicaltrials.eu/ctis-public/view/2022-502308-66-00